EU clinical trial 2023-508581-15-00: RandomizEd trial to DEtermine the efficacy and safety of FINErenone on morbidity and mortality among heart failure patients with left ventricular ejection fraction greater than or equal to 40% hospitalized due to an episode of acute decompensated Heart Failure (REDEFINE-HF)
Protocol code: 202301CPC
Sponsor: Colorado Prevention Center (Hospital/Clinic/Other health care facility). Phase: Therapeutic confirmatory (Phase III). Countries: Poland (ongoing, recruiting), Czechia (ongoing, recruiting), Hungary (ongoing, recruiting), Greece (ongoing, recruiting), Lithuania (ongoing, recruiting), Germany (ongoing, recruiting), Croatia (ongoing, recruiting), Spain (ongoing, recruiting), Italy (ongoing, recruiting), Austria (authorised, recruitment pending), Bulgaria (authorised, recruitment pending), Latvia (authorised, recruitment pending), Portugal (authorised, recruitment pending), Romania (authorised, recruitment pending), Slovakia (authorised, recruitment pending).
Therapeutic area(s): Diseases [C] - Cardiovascular Diseases [C14]
Gender: Female, Male. Age: 18-64 years, 65+ years. Enrolment: 2017.
Start date (EU): 2024-10-08. Decision date: 2024-06-24. Results received: No. Last updated: 2026-07-14.
Decision dates by country: LT: 2024-07-24, HR: 2024-08-09, HU: 2024-08-14, DE: 2024-07-22, CZ: 2024-08-14, IT: 2024-08-05, GR: 2024-08-19, AT: 2026-06-14, BG: 2026-06-12, LV: 2026-04-29, PT: 2026-04-28, RO: 2026-06-15, SK: 2026-06-09, ES: 2024-06-24, PL: 2024-08-13

Condition(s): Heart condition
Product: BAY 94-8862, BAY 94-8862 coated tablet, Finerenone, Finerenone

Primary endpoint: The primary study endpoint is a composite of total (first and subsequent) HF events (HF hospitalization or urgent visit for worsening HF) and CV death.
Endpoint(s): Secondary endpoints include treatment group difference in: 1.Time to first occurrence of the composite of CV death or HF event; 2. Total HF events; 3. Change from baseline to month 6 in KCCQ-TSS; 4. Time to CV death 5. Time to death from any cause

Source: https://euclinicaltrials.eu/ctis-public/view/2023-508581-15-00